EU clinical trial 2024-514801-69-00: A Multicenter Phase 2b Randomized, Double-Masked, Placebo-Controlled Dose-Ranging Study of TOUR006 in Participants with Thyroid Eye Disease.
Protocol code: TOUR006-T01
Sponsor: Tourmaline Bio Inc. (Pharmaceutical company). Phase: Therapeutic exploratory (Phase II). Countries: Poland (not authorised), France (ongoing, recruitment ended), Italy (ongoing, recruitment ended), Slovakia (ongoing, recruitment ended), Latvia (ongoing, recruitment ended), Spain (ongoing, recruitment ended).
Therapeutic area(s): Diseases [C] - Immune System Diseases [C20]
Gender: Female, Male. Age: 18-64 years, 65+ years. Enrolment: 48.
Start date (EU): 2025-04-02. Decision date: 2025-03-10. Results received: No. Last updated: 2026-06-08.
Decision dates by country: PL: 2025-03-17, SK: 2025-03-10, FR: 2025-03-12, LV: 2025-03-13, IT: 2025-03-12, ES: 2025-03-27

Condition(s): Thyroid Eye Disease
Product: L-Histidine, L-Histidine monohydrochloride monohydrate, Mannitol, Sucrose, Disodium EDTA dihydrate, Polysorbate 80, Water for injection

Primary endpoint: Percentage of participants achieving proptosis response (defined as a ≥2 mm reduction from baseline in the study eye without deterioration [≥2 mm increase] of proptosis in the fellow eye and without need for rescue therapy/intervention) in the TOUR006 treatment arms compared with the placebo arm at Week 20.
Endpoint(s): 1. Percentage of participants achieving a proptosis response in the TOUR006 treatment arms at Week 8, Week 16, Week 24, Week 32, Week 40, Week 44, Week 48, Week 56, Week 64, and Week 72., 2. Mean change from baseline in proptosis in the study eye at Week 8, Week 16, Week 20, Week 24, Week 32, Week 40, Week 44, Week 48, Week 56, Week 64, and Week 72., 3. Percentage of participants attaining a complete or near-complete CAS response (defined as CAS ≤1 in the study eye, without ≥2 point increase in CAS from baseline in the fellow eye, and without need for rescue therapy/intervention) at Week 8, Week 16, Week 20, Week 24, Week 32, Week 40, Week 44, Week 48, Week 56, Week 64, and Week 72., 4. Mean change from baseline in CAS in the study eye at Week 8, Week 16, Week 20, Week 24, Week 32, Week 40, Week 44, Week 48, Week 56, Week 64, and Week 72., 5. Percentage of participants attaining ≥1 grade decrease in diplopia at Week 8, Week 16, Week 20, Week 24, Week 32, Week 40, Week 44, Week 48, Week 56, Week 64, and Week 72., 6. Percentage of participants attaining resolution in diplopia at Week 8, Week 16, Week 20, Week 24, Week 32, Week 40, Week 44, Week 48, Week 56, Week 64, and Week 72., 7. Percentage of participants with inconstant diplopia at baseline attaining resolution of inconstant diplopia at Week 8, Week 16, Week 20, Week 24, Week 32, Week 40, Week 44, Week 48, Week 56, Week 64, and Week 72., 8. Percentage of participants with constant diplopia at baseline attaining resolution of constant diplopia at Week 8, Week 16, Week 20, Week 24, Week 32, Week 40, Week 44, Week 48, Week 56, Week 64, and Week 72., 9. Incidence of TEAEs by severity and SAEs through Week 72.

Source: https://euclinicaltrials.eu/ctis-public/view/2024-514801-69-00